EU clinical trial 2023-509371-16-00: A Phase 2, randomized, double-blind, placebo-controlled, parallel group study (TRANSFORM) to evaluate the efficacy and safety of GSK3915393 in participants with Idiopathic Pulmonary Fibrosis (IPF)
Protocol code: 220929
Sponsor: Glaxosmithkline Research & Development Limited (Pharmaceutical company). Phase: Therapeutic exploratory (Phase II). Countries: Germany (ended), Italy (ended), France (ended), Poland (ended), Spain (ended), Netherlands (ended).
Therapeutic area(s): Diseases [C] - Respiratory Tract Diseases [C08]
Gender: Female, Male. Age: 18-64 years, 65+ years. Enrolment: 78.
Status: Ended. Start date (EU): 2024-09-25. End date (EU): 2025-09-30. End date: 2025-10-02. Decision date: 2024-05-30. Results received: Yes. Last updated: 2025-03-04.
Decision dates by country: FR: 2024-06-03, DE: 2024-05-31, IT: 2024-06-05, NL: 2024-06-03, PL: 2024-06-05, ES: 2024-05-30

Condition(s): Idiopathic Pulmonary Fibrosis
Product: Placebo to Match GSK3915393 Tablet

Primary endpoint: Absolute change from baseline in FVC (mL) at Week 26
Endpoint(s): Absolute change from baseline in FVC (mL) at Weeks 4, 8, 12 and 18, Absolute change from baseline in FVC (% predicted) at Weeks 4, 8, 12, 18 and 26, Participants achieving relative decline from baseline in FVC (mL) ≤ 5% at Week 26, Participants with of AEs/SAEs over 26 weeks, "Participants with of clinically important findings in: - Vital signs, including blood pressure, body temperature, and pulse rate - Electrocardiogram - Laboratory: haematology, hepatobiliary, clinical chemistry "

Source: https://euclinicaltrials.eu/ctis-public/view/2023-509371-16-00